EU clinical trial 2024-513443-93-00: EORTC 2334-BTG: [177Lu]Lu-DOTATATE for recurrent MENingioma (LUMEN-1): a randomized phase II study
Protocol code: EORTC 2334-BTG
Sponsor: Europese Organisatie Voor Onderzoek En Behandeling Van Kanker Organisation Europeenne Pour La Recherche Et Le Traitement Du Cancer European Organi (Patient organisation/association). Phase: Therapeutic exploratory (Phase II). Countries: Austria (ongoing, recruiting), Spain (ongoing, recruiting), Norway (ongoing, recruiting), France (ongoing, recruiting), Germany (ongoing, recruiting), Denmark (authorised, recruitment pending), Italy (authorised, recruiting), Netherlands (authorised, recruitment pending).
Therapeutic area(s): Diseases [C] - Neoplasms [C04]
Gender: Female, Male. Age: 18-64 years, 65+ years. Enrolment: 106.
Start date (EU): 2025-03-10. Decision date: 2024-12-11. Results received: No. Last updated: 2026-02-05.
Decision dates by country: AT: 2024-12-15, NO: 2024-12-11, DE: 2024-12-11, ES: 2024-12-12, FR: 2024-12-11, DK: 2026-01-16, IT: 2026-02-04, NL: 2026-02-05

Condition(s): Recurrent Meningioma without local treatment options (Surgery or Radiotherapy)
Product: HYDROXYCARBAMIDE, BEVACIZUMAB, SUNITINIB, OCTREOTIDE, EVEROLIMUS, Lutathera 370 MBq/mL solution for infusion

Primary endpoint: The primary endpoint in this phase II study is progression-free survival (PFS) computed based on MRI-based RANO meningioma response criteria as assessed by the local investigator.
Endpoint(s): Best overall response (BOR, defined as complete response (CR), minor response (MR) or partial response (PR) during study treatment). Objective response (CR/MR/PR) rate and median CR/MR/PR duration. Complete response rate and median CR duration computed by MRI based on RANO meningioma response criteria as assessed by the local investigator., Overall survival (OS), OS probability at 6 (OS6) and 12 months (OS12), median OS (mOS)., Safety (CTCAE v.5.0) and tolerability ([177Lu]Lu-DOTATATE only)., Change from baseline in HRQoL in terms of the global QoL, cognitive functioning, social functioning and fatigue at week 24., Change of neurological function (NANO scale) from baseline during study treatment.

Source: https://euclinicaltrials.eu/ctis-public/view/2024-513443-93-00